EU clinical trial 2024-516827-14-00: Bioequivalence of Lisdexamfetamine dimesylate 20 mg Capsules in Healthy Participants Under Fasting Conditions.
Protocol code: BLCL-LIS-EU-02
Sponsor: Pharmaplot P.C. (Pharmaceutical company). Phase: Human Pharmacology (Phase I)- Bioequivalence Study. Countries: Portugal (ended).
Therapeutic area(s): Not possible to specify
Gender: Female, Male. Age: 18-64 years. Enrolment: 24.
Status: Ended. Start date (EU): 2025-03-10. End date (EU): 2025-04-15. Decision date: 2024-10-02. Results received: No. Last updated: 2025-03-25.

Condition(s): No medical condition.

Source: https://euclinicaltrials.eu/ctis-public/view/2024-516827-14-00